EU clinical trial 2024-514483-11-00: PHASE II STUDY OF TOTAL MARROW AND LYMPHOID IRRADIATION (TMLI) ADMINISTERED IN COMBINATION WITH A REDUCED-INTENSITY REGIMEN BASED ON FLUDARABINE AND MELPHALAN AS CONDITIONING FOR ALLOGENEIC HEMATOPOIETIC STEM CELL TRANSPLANTATION (AHSCT) IN PATIENTS WITH HIGH-RISK MYELODYSPLASTIC SYNDROME OR ACUTE MYELOID LEUKEMIA.
Protocol code: TMLI-RI
Sponsor: Fundacion Publica Andaluza Para La Gestion De La Investigacion En Salud De Sevilla (Laboratory/Research/Testing facility). Phase: Therapeutic exploratory (Phase II). Countries: Spain (ongoing, recruiting).
Therapeutic area(s): Diseases [C] - Neoplasms [C04]
Gender: Female, Male. Age: 18-64 years, 65+ years. Enrolment: 46.
Status: Ongoing, recruiting. Start date (EU): 2025-02-10. Decision date: 2024-11-13. Results received: No. Last updated: 2025-10-20.

Condition(s): High-Risk Myelodisplastic Syndrome OR Acute Myeloid Leukemia.
Product: MELPHALAN, CYCLOPHOSPHAMIDE, TACROLIMUS, MYCOPHENOLATE MOFETIL, FLUDARABINE PHOSPHATE, MYCOPHENOLATE MOFETIL

Primary endpoint: The primary endpoint for the primary patient safety segment of this study is toxicity. Toxicity will be graded on both the Bearman Scale (Appendix I) and the NCI CTCAE Scale and v5.0 (Appendix II)., The primary endpoint is 2 year progression-free survival (PFS). PFS will be defined as time from the start of treatment to the date of death, disease relapse/progression, or date of last follow-up, and estimated using the Kaplan-Meier method. Patients are considered a failure for this endpoint if they die or if they relapse/progress. The time to this event is the time from the start of protocol therapy to death, relapse/progression, or the last follow-up, whichever comes first.
Endpoint(s): Overall survival (OS): Patients are considered a failure for this endpoint if they die, regardless of the cause. The time to this event is the time from the start of protocol therapy to death, or the last follow-up, whichever comes first., Cumulative incidence (CI) of recurrence/progression: The event is relapse/progression either extramedullary (EM) or at bone marrow (BM) (date and place). The time to this event is measured from the start of therapy. Death without relapse/progression is considered a competing risk. Surviving patients with no history of relapse/progression are censored at the time of last follow-up., Complete remission (CR) rate at day 30 post-transplant: The event is whether or not the patient has a documented CR on day 30. Time to event is measured from the day of infusion to the time of CR., Non-relapse mortality (NRM): Patients are considered a failure for this endpoint if they die from causes other than relapse or progression. NRM is measured from the start of therapy until non-disease-related death, or the last follow-up, whichever comes first., Measurable residual disease (MRD): MRD monitoring assessed by multiparameter flow cytometry at 30, 90, 180, 360, 575 days, and 2 years post-transplant., Incidence of infection: Microbiologically documented infections will be reported by site of illness, date of onset, severity, and resolution, if applicable. This data will be captured through the case report form and will be collected from day 0 to 100 days after transplantation., Toxicities/Adverse Events: The Bearman Scale (non-hematologic) and CTCAE v. 5.0 (hematologic) will be employed. Dose/dose-volume toxicity characterization across organs will be assessed., Acute graft-versus-host disease (GVHD) grades 2-4 and 3-4: Acute graft-versus-host disease is classified according to the consensus classification. The first day of onset of acute GVHD to a certain degree will be used to calculate the cumulative incidence curves for that grade of GVHD. The endpoint will be assessed from day 0 to 100 days post-transplant., Chronic graft-versus-host disease (GVHD): Chronic graft-versus-host disease is graded according to the NIH consensus staging. The first day of onset of chronic GVHD will be used to calculate cumulative incidence curves.

Source: https://euclinicaltrials.eu/ctis-public/view/2024-514483-11-00